EU clinical trial 2024-516681-10-01: Spontaneous Retinal Arterial Pulsations (SRAPs) as a Prognostic Determinant of Central Retinal Vein Occlusions (CRVOs) in patients treated or not with intravitreal injections of aflibercept
Protocol code: MMT_2020_33
Sponsor: Fondation A De Rothschild (Hospital/Clinic/Other health care facility). Phase: Therapeutic exploratory (Phase II). Countries: France (ended).
Therapeutic area(s): Diseases [C] - Eye Diseases [C11]
Gender: Female, Male. Age: 18-64 years, 65+ years. Enrolment: 60.
Status: Ended. Start date (EU): 2021-03-24. End date (EU): 2025-03-17. Decision date: 2024-11-12. Results received: Yes. Last updated: 2024-11-12.

Condition(s): central retinal vein occlusions
Product: Eylea 40 mg/mL solution for injection in pre-filled syringe

Primary endpoint: Change in visual acuity (BCVA on ETDRS scale) in letters read and validated between the start of treatment and 1 year.
Endpoint(s): Macular edema will be determined by the ophthalmologist from the OCT examination, Measurement of macular thickness in μm is performed using OCT-integrated measurement software, CRVO complications will be collected at one year from the patient's record, The number of aflibercept injections during the first year of follow-up will be collected at one year from the patient's record, The time between the last 2 injections of aflibercept will be collected at one year from the patient's file

Source: https://euclinicaltrials.eu/ctis-public/view/2024-516681-10-01